EU clinical trial 2023-503645-63-00: Amoxicillin alone versus amoxicillin/clavulanate for community-acquired pneumonia in patients aged 65 years or older, and hospitalized in a non-intensive care unit ward: a non-inferiority randomized controlled trial _ CAPTAIN
Protocol code: RC20_0015
Sponsor: Centre Hospitalier Universitaire De Nantes (Hospital/Clinic/Other health care facility). Phase: Therapeutic confirmatory (Phase III). Countries: France (ongoing, recruiting).
Therapeutic area(s): Diseases [C] - Bacterial Infections and Mycoses [C01]; Diseases [C] - Respiratory Tract Diseases [C08]
Gender: Female, Male. Age: 65+ years. Enrolment: 326.
Status: Ongoing, recruiting. Start date (EU): 2024-04-25. Decision date: 2024-01-08. Results received: No. Last updated: 2026-01-28.

Condition(s): Patients aged 65 years or older, hospitalized in a non-ICU ward for a community acuquired pneumonia, and treated with narrow-spectrum versus broad-spectrum antimicrobial therapy
Product: AMOXICILLINE PANPHARMA 1 g, poudre pour solution injectable, AMOXICILLIN/ACIDE CLAVULANIQUE ZYDUS FRANCE 500 mg/62,5 mg, comprimé pelliculé (rapport amoxicilline/acide clavulanique : 8/1), AMOXICILLINE/ACIDE CLAVULANIQUE PANPHARMA 1 g/200 mg ADULTES, poudre pour solution injectable, AMOXICILLINE ARROW 500 mg, gélule

Primary endpoint: clinical success rate at Day 30 (Montassier et al., 2019) since admission, defined as survival after completion of antibiotic treatment course, resolution of signs and symptoms of the infection (cough, purulent sputum production, dyspnea, or pleuritic chest pain) present at baseline with no new symptoms or complications attributable to CAP and no need for further antibacterial therapy
Endpoint(s): Early clinical response will be defined as survival with improvement of one or more levels relative to baseline in two or more symptoms of CAP and no worsening of one or more levels in other symptoms of community-acquired bacterial pneumonia, without receipt of rescue antibacterial therapy, The proposed endpoint of clinical cure after the end of treatment is defined as resolution in relevant signs and symptoms reported at baseline, no worsening of symptoms, and no change in antimicrobial regimen, Days taking antibiotics from the first dose until the interruption of any antibiotic treatment during hospitalization and at late follow-up at Day 30 after hospital admission (to identify the use of any other antibiotic after hospital discharge defined as no IV, regain of autonomy identical to baseline, good clinical response and favorable evolution following initiation of antibiotics, other criteria left at the discretion of the investigators according to centers’ practices), All-cause mortality at Day 30 after hospital admission, Number of positive polymerase chain reaction (PCR)-positive Clostridium difficile among patients with diarrhea, Number of deaths during hospitalization, Number of patients transferred to the ICU during the Day 30 follow- up, Number of hospital readmissions and CAP recurrence up to day 30 from hospital admission, Number of adverse events attributable to antibiotics and number of days with adverse events up to day 30 from hospital admission, Number of days of antibiotic treatment taken, Total number of days in the hospital during the Day 30 follow-up, Agreement between early clinical response (main endpoint) and the investigator’s clinical judgement (clinical success or clinical failure)

Source: https://euclinicaltrials.eu/ctis-public/view/2023-503645-63-00